EU clinical trial 2023-505131-13-01: Comparative clinical trial of efficacy and satisfaction of 2% gel lidocaine versus tetracaine/oxybuprocaine anesthetic eye drops in patients undergoing needing techniques in ophthalmology consultations. Anesthesia in Needling with Lidocaine (ANELI)
Protocol code: ANELI 003
Sponsor: Hospital Del Mar (Hospital/Clinic/Other health care facility). Phase: Therapeutic use (Phase IV). Countries: Spain (temporarily halted).
Therapeutic area(s): Diseases [C] - Eye Diseases [C11]
Gender: Female, Male. Age: 18-64 years, 65+ years. Enrolment: 60.
Status: Temporarily halted. Start date (EU): 2024-01-11. Decision date: 2023-12-04. Results received: No. Last updated: 2023-12-04.

Condition(s): Glaucoma
Product: Ophtesic 20 mg/g, gel oftálmico en envase unidosis, COLIROFTA ANESTÉSICO DOBLE 1 MG/ML + 4 MG/ML COLIRIO EN SOLUCIÓN

Primary endpoint: Pain: Numerical rating scale (NRS) from 0 to 10, Surgeon comfort/degree of patient cooperation: numerical rating scale (NRS) from 0 to 10
Endpoint(s): Demographic variables: sex, age, Number of tetracaine booster drops, Need for oral analgesia: analgesic and dose used, Ocular surface condition: Measured according to the Oxford Scale from 0 to 5., Security: number of intra and post needling complications, IOP: Intraocular pressure in mmHg measured by Goldmann applanation tonometry., Absolute success: Number of patients (and percentage) controlled without antihypertensive therapy at 3 months Relative success: Number of patients controlled (and percentage) on hypotensive therapy at 3 months.

Source: https://euclinicaltrials.eu/ctis-public/view/2023-505131-13-01